EU clinical trial 2023-506634-70-00: Sacubitril-Valsartan in Heart Failure with Preserved Ejection Fraction and Secondary Mitral Valve Regurgitation (PRAISE-MR)
Sponsor: Ziekenhuis Oost Limburg (Hospital/Clinic/Other health care facility). Phase: Therapeutic use (Phase IV). Countries: Belgium (ended).
Therapeutic area(s): Diseases [C] - Cardiovascular Diseases [C14]
Gender: Female, Male. Age: 18-64 years, 65+ years. Enrolment: 110.
Status: Ended. Start date (EU): 2024-02-29. End date (EU): 2026-03-10. Decision date: 2023-10-11. Results received: Yes. Last updated: 2023-10-11.

Condition(s): Heart failure with preserved ejection fraction Secundary mitral valve regurgitation
Product: Entresto 97 mg/103 mg film-coated tablets, Entresto 24 mg/26 mg film-coated tablets, Entresto 49 mg/51 mg film-coated tablets

Primary endpoint: Change in the mPAP/CO slope between randomization and 6 months thereafter
Endpoint(s): Changes in (1) Peak VO2 (2) Mitral effective regurgitant orifice area (EROA) (3) Natriuretic peptide levels (NTproBNP) (4) Left atrial volume (Left Atrial Volume Index, LAVI) (5) Left atrial function (Peak Atrial Longitudinal Strain, PALS) (6) VE/VCO2 slope (7) Patient reported outcomes (Kansas City Cardiomyopathy Questionnaire, KCCQ-12)

Source: https://euclinicaltrials.eu/ctis-public/view/2023-506634-70-00